EU clinical trial 2024-516598-60-00: A Randomized Phase 3 Study of Sitravatinib in Combination with Nivolumab Versus Docetaxel in Patients with Advanced Non-Squamous Non-Small Cell Lung Cancer with Disease Progression On or After Platinum-Based Chemotherapy and Checkpoint Inhibitor Therapy (SAPPHIRE)
Protocol code: 516-005
Sponsor: Mirati Therapeutics Inc. (Pharmaceutical company). Phase: Therapeutic confirmatory (Phase III). Countries: Spain (ended), Netherlands (ended), Italy (ended).
Therapeutic area(s): Diseases [C] - Respiratory Tract Diseases [C08]
Gender: Female, Male. Age: 18-64 years, 65+ years. Enrolment: 196.
Status: Ended. Start date (EU): 2020-12-18. End date (EU): 2025-09-30. End date: 2025-10-01. Decision date: 2024-08-27. Results received: No. Last updated: 2025-09-24.
Decision dates by country: IT: 2024-09-23, NL: 2024-08-29, ES: 2024-08-27

Condition(s): Advanced Non-Squamous Non-Small Cell Lung Cancer
Product: Sitravatinib, Sitravatinib, TAXOTERE 20 mg/1 ml concentrate for solution for infusion, OPDIVO 10 mg/mL concentrate for solution for infusion.

Primary endpoint: Overall Survival (OS)
Endpoint(s): Safety characterized by type, incidence, severity, timing, seriousness and relationship to study treatment of adverse events, laboratory abnormalities, and number of patients discontinuing study treatment due to an adverse event., Secondary efficacy endpoints: - Objective Response Rate (ORR) as defined by Response Evaluation Criteria in Solid Tumors version 1.1 (RECIST 1.1). - Duration of Response (DOR); - Clinical Benefit Rate (CBR); - Progression-Free Survival (PFS); and - 1-Year Survival Rate., Blood plasma concentrations of MGCD516., Patient reported outcome (PROs): - Lung Cancer Symptom Scale (LCSS); and - European Quality of Life Five Dimensions Questionnaire (EQ-5D-5L).

Source: https://euclinicaltrials.eu/ctis-public/view/2024-516598-60-00